EU clinical trial 2024-520359-26-00: An Open-Label, Dose-Ranging Study to Evaluate the Safety, Tolerability, and Efficacy of Intravenous NVG-2089 in Participants with Immune Thrombocytopenia
Protocol code: NVG-2089-200
Sponsor: Nuvig Therapeutics Inc. (Pharmaceutical company). Phase: Therapeutic exploratory (Phase II). Countries: Poland (ongoing, recruiting), Greece (ongoing, recruiting), Spain (ongoing, recruiting).
Therapeutic area(s): Diseases [C] - Immune System Diseases [C20]
Gender: Female, Male. Age: 18-64 years, 65+ years. Enrolment: 60.
Status: Ongoing, recruiting. Start date (EU): 2025-08-20. Decision date: 2025-08-12. Results received: No. Last updated: 2026-07-03.
Decision dates by country: ES: 2025-08-12, GR: 2025-08-14, PL: 2025-08-18

Condition(s): Immune Thrombocytopenia (ITP)
Product: NVG-2089, IMMUNOGLOBULINS, NORMAL HUMAN, FOR INTRAVASCULAR ADM.

Primary endpoint: Incidence, nature, and severity of TEAEs, and serious adverse events (SAEs)
Endpoint(s): 1. Percent of participants achieving a response. − For participants with a dose-specific baseline platelet count <30,000 cells/mm3, a response is defined as a doubling of the dose-specific baseline platelet count or a platelet count of ≥50,000 cells/mm3; − For participants with a dose-specific baseline platelet count ≥30,000 cells/mm3, a response is defined as an increase in the platelet count to ≥20,000 cells/ mm3 from dose-specific baseline, 2. Duration of response, 3. Absolute and percent change from the dose specific baseline in platelet count, 4. PK parameters of NVG-2089

Source: https://euclinicaltrials.eu/ctis-public/view/2024-520359-26-00